EU clinical trial 2022-502100-70-00: A Phase 2, Multicenter, Multi Arm, Study to Evaluate MK-1308A (Coformulated quavonlimab (MK-1308)/pembrolizumab) Versus Other Treatments in Participants with Microsatellite Instability-High (MSI-H) or Mismatch Repair Deficient (dMMR) Stage IV Colorectal Cancer: (MK-1308A-008)
Protocol code: MK-1308A-008
Sponsor: Merck Sharp & Dohme LLC (Pharmaceutical company). Phase: Phase II and Phase III (Integrated). Countries: Denmark (ended), France (ended), Spain (ended), Lithuania (ended), Germany (ended), Estonia (ended), Hungary (ended), Romania (ended), Belgium (ended), Netherlands (ended), Italy (ended), Poland (ended), Greece (ended).
Therapeutic area(s): Diseases [C] - Neoplasms [C04]
Gender: Female, Male. Age: 18-64 years, 65+ years. Enrolment: 244.
Status: Ended. Start date (EU): 2021-06-23. End date (EU): 2026-07-14. Decision date: 2023-08-31. Results received: No. Last updated: 2026-06-25.
Decision dates by country: BE: 2023-09-05, HU: 2023-08-31, EE: 2023-09-01, DE: 2023-09-05, DK: 2023-09-01, GR: 2023-10-06, IT: 2023-09-22, FR: 2023-09-04, RO: 2023-09-04, PL: 2023-09-25, ES: 2023-09-05, LT: 2023-09-12, NL: 2023-09-19

Condition(s): Participants with Microsatellite Instability-High (MSI-H) or Mismatch Repair Deficient (dMMR) Stage IV Colorectal Cancer
Product: MK-1308A, MK-4830, MK-7684A, KEYTRUDA 25 mg/mL concentrate for solution for infusion, MK-4280A, MK-4830

Primary endpoint: Objective Response Rate (ORR) per Response Evaluation Criteria in Solid Tumors version 1.1 (RECIST 1.1) as assessed by Blinded Independent Central Review (BICR)
Endpoint(s): Duration of Response (DOR) per RECIST 1.1 as assessed by BICR, Progression-Free Survival (PFS) per RECIST 1.1 as assessed by BICR, PFS per RECIST 1.1 as assessed by Investigator, ORR per RECIST 1.1 as assessed by Investigator, DOR per RECIST 1.1 as assessed by Investigator, Overall Survival (OS), Number of Participants Who Experienced an Adverse Event (AE), Number of Participants Discontinuing Study Treatment Due to an AE

Source: https://euclinicaltrials.eu/ctis-public/view/2022-502100-70-00